EU clinical trial 2024-513058-31-00: Characterisation of availability in the body of the active substance(s) of the newly developed patch Esflurbiprofen Topical System (EFTS) in comparison with a marketed oral flurbiprofen-containing tablet formulation after multiple dose administration including adhesion assessment of the patch - a phase I, open-label, randomised, 2-period, cross-over study in healthy subjects
Protocol code: TK-254RX-0102
Sponsor: Teikoku Seiyaku Co. Ltd. (Pharmaceutical company). Phase: Human Pharmacology (Phase I)- Other. Countries: Germany (ended).
Therapeutic area(s): Diseases [C] - Musculoskeletal Diseases [C05]
Gender: Female, Male. Age: 18-64 years. Enrolment: 26.
Status: Ended. Start date (EU): 2025-01-07. End date (EU): 2025-02-24. Decision date: 2024-10-09. Results received: No. Last updated: 2024-10-09.

Condition(s): bioavailability and patch adhesion trial with healthy volunteers, therapeutic indication not studied

Source: https://euclinicaltrials.eu/ctis-public/view/2024-513058-31-00